EU clinical trial 2024-516650-22-00: Cabozantinib and Nivolumab among older patients with renal-cell carcinoma, a prospective cohort with geriatric, pharmacologic and patient-reported-outcome evaluation (CABOLD)
Protocol code: 2024/3873 CABOLD
Sponsor: Institut Gustave Roussy (Hospital/Clinic/Other health care facility). Phase: Therapeutic use (Phase IV). Countries: France (ongoing, recruiting).
Therapeutic area(s): Diseases [C] - Neoplasms [C04]
Gender: Female, Male. Age: 65+ years. Enrolment: 50.
Status: Ongoing, recruiting. Start date (EU): 2025-05-16. Decision date: 2025-02-21. Results received: No. Last updated: 2026-06-30.

Condition(s): Renal carcinoma
Product: CABOMETYX 40 mg film-coated tablets, OPDIVO 10 mg/mL concentrate for solution for infusion., CABOMETYX 20 mg film-coated tablets

Primary endpoint: Treatment patterns, including starting dose of Cabozantinib, dose interruption, dose modification related to all grade toxicity at 24 weeks.
Endpoint(s): Overall response rate based on radiological evaluation, Overall-survival, Progression free survival, Duration of response, Tolerance based on physicians and patients reports, Unplanned hospitalizations, emergency departments visits and falls, Patients reported quality of life (FACT-G and FACIT-TS-G),, Exploratory analyses to assess potential associations between G-CODE parameters and pharmacological monitoring of Cabozantinib with safety, efficacy, and QoL criteria

Source: https://euclinicaltrials.eu/ctis-public/view/2024-516650-22-00